EU clinical trial 2023-510320-71-00: PEVOsq: Phase II basket trial evaluating the efficacy of a combination of pembrolizumab and vorinostat in patients with recurrent and/or metastatic squamous cell carcinoma
Protocol code: UC-GMP-1908
Sponsor: Unicancer (Hospital/Clinic/Other health care facility). Phase: Therapeutic exploratory (Phase II). Countries: France (ended).
Therapeutic area(s): Diseases [C] - Neoplasms [C04]
Gender: Female, Male. Age: 18-64 years, 65+ years. Enrolment: 112.
Status: Ended. Start date (EU): 2020-10-27. End date (EU): 2024-11-26. Decision date: 2024-02-22. Results received: No. Last updated: 2025-05-23.

Condition(s): Squamous cell carcinoma of vulva/vagina, Squamous cell carcinoma of the head and neck, Squamous cell carcinoma of penis, Squamous cell carcinoma of cervix, Squamous cell carcinoma of anus
Product: KEYTRUDA 25 mg/mL concentrate for solution for infusion

Primary endpoint: Investigators will assess the ORR. The ORR is defined in each cohort as the percentage of evaluable patients for ORR, designate as the proportion of patients with best response of complete response (CR) or a partial response (PR) during treatment according to RECIST v1.1.
Endpoint(s): ORR defined as the proportion of patients with best response of CR or PR during treatment, as assessed by a central radiological panel according to RECIST v1.1, iORR defined as the proportion of patients with best response of CR or PR during treatment, as assessed by a central radiological panel according to immune-specific response criteria (iRECIST, Appendix 7)., DOR will be evaluated in patients with either a complete response (CR) or partial response (PR). DOR is defined as the time from the first assessment of a CR or PR until the date of the first occurrence of progressive disease (PD) or death from any cause (if death occurred within predefined period), whichever occurs first., PFS is defined per RECIST1.1 as the time from inclusion until disease progression (per RECIST v1.1) or death from any cause, whichever occurs first. At the time of analysis, a patient alive and without disease progression will be censored at the date of the last tumor assessment. Patients alive without disease progression who started a new anticancer therapy will be censored at the date of the last tumor assessment prior to the start of the new anticancer therapy., iPFS is defined per iRECIST as the time from inclusion until confirmed disease progression (per iRECIST), or death from any cause, whichever occurs first. At the time of analysis, a patient alive and without progression will be censored at the date of the last tumor assessment. Patients alive without disease progression who started a new anti-cancer therapy will be censored at the date of the last tumor assessment prior to the start of the new anticancer therapy., OS is defined as the time from inclusion until death from any cause. Patients who are alive at last follow-up news will be censored at this date., The safety will be evaluated according to the incidence of adverse events (AEs) graded by NCICTCAE v5.0 (Appendix 8): - In each cohort. - In the overall study population.

Source: https://euclinicaltrials.eu/ctis-public/view/2023-510320-71-00